EU clinical trial 2024-518021-16-00: Effectiveness and cost-effectiveness of Ozone therapy in patients with pain secondary to chemotherapy-induced peripheral neuropathy. Randomized, triple-blind clinical trial.
Protocol code: O3NPIQ
Sponsor: Dr. Bernardino Clavo Varas (Health care). Phase: Phase II and Phase III (Integrated). Countries: Spain (ongoing, recruiting).
Therapeutic area(s): Diseases [C] - Nervous System Diseases [C10]
Gender: Female, Male. Age: 18-64 years, 65+ years. Enrolment: 42.
Status: Ongoing, recruiting. Start date (EU): 2020-11-30. Decision date: 2024-09-26. Results received: No. Last updated: 2024-09-26.

Condition(s): Pain secondary to chemotherapy-induced peripheral neuropathy
Product: The Placebo is the diatomic allotrope of oxygen (O2) (Oxígeno Medicinal Gas Carburos Metálicos, 99'5%), Oxígeno Medicinal Gas Carburos Metálicos, 99.5% v/v gas comprimido medicinal

Primary endpoint: the “average pain” level according to the Brief Pain Inventory-Short Form (BPI-SF)., Direct hospital costs. The use of hospital resources (medication, tests, medical visits, medical supplies, etc.) and the associated cost will be collected (from the information generated in the Admission, Accounting Management and Analytical Accounting Services of our Hospital).
Endpoint(s): 1. Quality of Life (QOL) measured by "EQ-5D-5L" questionnaire, 2. Quality of Life (QOL) measured by "SF-36v2, 1 week" questionnaire., 3. Biochemical parameters of oxidative stresss, 4. Biochemical parameters of inflammation, 5. Hyperspectral image of painful area, 6. Levels of anxiety and depression according to the Hamilton scale, 7. Nerve conduction studies in the painful area, 8. Toxicity of rectal ozone therapy in these patients., 9. Acceptability of a shared decision making (SDM) tool among professionals and patients

Source: https://euclinicaltrials.eu/ctis-public/view/2024-518021-16-00